EU clinical trial 2023-510444-21-00: A prospective, randomised, Controlled, Open-label, Multicentre phase III study to evaluate efficacy and safety of Peptide Receptor Radionuclide Therapy (PRRT) with 177Lu-Edotreotide compared to targeted molecular therapy with Everolimus in patients with inoperable, progressive, somatostatin receptor-positive (SSTR+), neuroendocrine tumours of gastroenteric or pancreatic origin (GEP-NET).
Protocol code: ITM-LET-01
Sponsor: ITM Solucin GmbH (Pharmaceutical company). Phase: Therapeutic confirmatory (Phase III). Countries: Poland (ongoing, recruitment ended), Austria (ended), Netherlands (ongoing, recruitment ended), Spain (ongoing, recruitment ended), France (ongoing, recruitment ended), Germany (ongoing, recruitment ended), Italy (ongoing, recruitment ended), Czechia (ongoing, recruitment ended), Belgium (ongoing, recruitment ended).
Therapeutic area(s): Diseases [C] - Neoplasms [C04]
Gender: Female, Male. Age: 18-64 years, 65+ years. Enrolment: 268.
Start date (EU): 2017-11-24. Decision date: 2024-06-25. Results received: No. Last updated: 2026-06-08.
Decision dates by country: AT: 2024-07-03, DE: 2024-06-27, PL: 2024-07-22, NL: 2024-06-25, ES: 2024-07-16, IT: 2024-07-01, CZ: 2024-07-01, BE: 2024-06-27, FR: 2024-06-28

Condition(s): Neuroendocrine tumours of gastroenteric or pancreatic origin
Product: 177Lu-Edotreotide, Arginine-Lysine solution for infusion, Afinitor 5 mg tablets, Afinitor 10 mg tablets

Primary endpoint: 1. Progression-free survival (PFS)
Endpoint(s): 1. Objective response rate (ORR), % patients achieving PR or CR as best outcome, 2. Overall survival (OS), 3. Safety and tolerability-Measured TER, percentage depart from baseline value, 4. Safety and tolerability-Calculated GFR, percentage depart from baseline value, 5. Safety and tolerability-Renal volume (Vkidney), percentage depart from baseline value, 6. Safety and tolerability-Frequency of occurrence and severity of abnormal findings in safety investigations (vital signs, 12-lead ECG, clinical laboratory, adverse events), 7. Health-related quality of life (HRQL)- Maximum HRQL improvement (EORTC QLQ-C30 and GI.NET21 questionnaires) total scores, relative to baseline, 8. Health-related quality of life (HRQL)- Duration of maximum HRQL improvement, 9. Health-related quality of life (HRQL)- Time to HRQL deterioration, defined as the time from randomisation to first HRQL deterioration, 10. Dosimetry- Full dosimetry assessments of target organs and tumour lesions, 11. Dosimetry- Cumulative absorbed dose (in Gy) from 177Lu-edotreotide to target tumour lesions, estimated from 177Lu-edotreotide dosimetry after first dose, 12. Dosimetry- Sub-study A patients: cumulative absorbed dose to kidneys and to tumour lesions extrapolated from absorbed dose estimated at D1 compared with the cumulative absorbed dose measured at the different administration times (i.e. D1 to D4), 13. Dosimetry- Sub-study B patients: absorbed dose (in Gy) determined by 3D dosimetry compared to absorbed dose values obtained by planar (2D) and hybrid (2D/3D) dosimetry, 14. Dosimetry- Sub-study C patients: bone marrow absorbed dose (in Gy) extrapolated from blood radioactivity, 15. Pharmacokinetics (Sub-study C) Urine radioactivity in percentage of injected activity (%IA) at pre-defined intervals within 48 hours post-injection to assess excretion pattern, 16. Pharmacokinetics (Sub-study C) Blood radioactivity in %IA at pre-defined time points within 7 days post-injection to assess clearance pattern, 17. Pharmacokinetics (Sub-study C)_Radiochemical purity assessed through HPLC of urine samples collected within 48 hours post-injection

Source: https://euclinicaltrials.eu/ctis-public/view/2023-510444-21-00